EU clinical trial 2024-515695-13-00: Benefits of early discontinuation of antibiotic therapy versus standard management in elderly patients hospitalized for viral infection: a multicenter, open-label, cluster-randomized controlled study
Protocol code: PI2023_843_0153
Sponsor: Centre Hospitalier Universitaire Amiens Picardie (Hospital/Clinic/Other health care facility). Phase: Phase III and phase IV (Integrated). Countries: France (ongoing, recruiting).
Therapeutic area(s): Diseases [C] - Respiratory Tract Diseases [C08]
Gender: Female, Male. Age: 65+ years. Enrolment: 256.
Status: Ongoing, recruiting. Start date (EU): 2026-02-02. Decision date: 2025-02-14. Results received: No. Last updated: 2026-03-11.

Condition(s): elderly patients hospitalized for viral infections
Product: CEFTRIAXONE, AMOXICILLIN AND BETA-LACTAMASE INHIBITOR, PIPERACILLIN AND BETA-LACTAMASE INHIBITOR, PYOSTACINE 500 mg, comprimé pelliculé

Primary endpoint: Number of days without antibiotics at D30
Endpoint(s): Side effects of antibiotics: (collected in the eCRF at each occurrence) o Clostridial colitis, o venitis, o diarrhea, o nausea, o vomiting, o BMR germ colonization, o allergy, o other attributable effect: specify, Other complications: o nosocomial infections, o complications of decubitus, o intra-hospital mortality from any cause, o confusion, o other complication attributable to hospitalization and the reason for hospitalization: specify, Mortality at M1 and M3 or autonomy: ADL and IADL score at M1 and M3 (compared to those 15 days before hospitalization), Duration of hospitalization in acute care (in days), Number of days without antibiotics at M3

Source: https://euclinicaltrials.eu/ctis-public/view/2024-515695-13-00